EU clinical trial 2024-518489-29-00: A Phase 1/2 Multicenter, Open-label, Dose Escalation, Safety and Efficacy Study of Subretinal Administration of Dual AAV8.MYO7A, AAVB-081 in Participants with Usher Syndrome Type 1B (USH1B) Retinitis Pigmentosa
Protocol code: 081-101
Sponsor: Aavantgarde Bio S.r.l. (Pharmaceutical company). Phase: Phase I and Phase II (Integrated)- First administration to humans. Countries: Italy (ongoing, recruitment ended).
Therapeutic area(s): Diseases [C] - Eye Diseases [C11]
Gender: Female, Male. Age: 18-64 years. Enrolment: 9.
Status: Ongoing, recruitment ended. Start date (EU): 2024-07-01. Decision date: 2024-11-19. Results received: No. Last updated: 2026-05-25.

Condition(s): Usher Syndrome Type 1B (USH1B) Retinitis Pigmenotsa
Product: AAVB-081, PREDNISONE

Primary endpoint: The incidence and severity of adverse events (AEs) including serious adverse events (SAEs), treatment emergent adverse events (TEAEs) and dose limiting toxicities (DLTs) at 24 months., The incidence and nature of DLTs at each dose level at 24 months

Source: https://euclinicaltrials.eu/ctis-public/view/2024-518489-29-00